EU clinical trial 2024-519932-17-00: Etude de bioéquivalence entre Circadin et Melatonin PILEJE LP 2 mg
Protocol code: CHAMM / OP113523.PIL
Sponsor: Pileje (Pharmaceutical company). Phase: Human Pharmacology (Phase I)- Bioequivalence Study. Countries: France (authorised, recruitment pending).
Therapeutic area(s): Diseases [C] - Hormonal diseases [C19]
Gender: Male. Age: 18-64 years. Enrolment: 24.
Status: Authorised, recruitment pending. Decision date: 2025-08-28. Results received: No. Last updated: 2025-08-28.

Condition(s): Primary insomnia characterized by poor quality of sleep

Source: https://euclinicaltrials.eu/ctis-public/view/2024-519932-17-00